EU clinical trial 2025-524652-63-00: A study of enzomenib investigating potential drug-drug interactions and the effect of liver impairment in adult patients with advanced cancer
Protocol code: DSP-5336-103
Sponsor: Sumitomo Pharma America Inc. (Pharmaceutical company). Phase: Human Pharmacology (Phase I)- Other. Countries: Spain (authorised, recruitment pending), Bulgaria (authorised, recruitment pending).
Therapeutic area(s): Diseases [C] - Neoplasms [C04]
Gender: Female, Male. Age: 18-64 years, 65+ years. Enrolment: 33.
Status: Authorised, recruitment pending. Decision date: 2026-08-04. Results received: No. Last updated: 2026-08-07.
Decision dates by country: BG: 2026-08-07, ES: 2026-08-04

Condition(s): Advanced Cancer

Source: https://euclinicaltrials.eu/ctis-public/view/2025-524652-63-00